EU clinical trial 2023-509431-29-00: Treatment with Risedronate for dilated cardiomyopathy due to Troponin T alteration due to K210 deletion.
Protocol code: IMIB-TRISMD-2023-02
Sponsor: Fundacion Para La Formacion E Investigacion Sanitaria De La Region De Murcia (Educational Institution). Phase: Therapeutic exploratory (Phase II). Countries: Spain (ongoing, recruiting).
Therapeutic area(s): Diseases [C] - Cardiovascular Diseases [C14]
Gender: Female, Male. Age: 18-64 years, 65+ years. Enrolment: 5.
Status: Ongoing, recruiting. Start date (EU): 2025-04-08. Decision date: 2024-08-26. Results received: No. Last updated: 2024-11-22.

Condition(s): Dilated cardiomyopathy
Product: Actonel 5 mg comprimidos recubiertos con película

Primary endpoint: Change in LVEF, measured by echocardiography, at 6 months.
Endpoint(s): Improvement in functional capacity, measured in the stress test with oxygen consumption, at 6 months.

Source: https://euclinicaltrials.eu/ctis-public/view/2023-509431-29-00